EU clinical trial 2024-511878-67-00: TransBronchial Needle injection of Tremelimumab in early-stage NSCLC patients (TALENT)
Protocol code: 2024-511878-67-00
Sponsor: Amsterdam UMC Stichting (Hospital/Clinic/Other health care facility). Phase: Phase I and Phase II (Integrated)- Other. Countries: Netherlands (ongoing, recruiting).
Therapeutic area(s): Diseases [C] - Respiratory Tract Diseases [C08]; Diseases [C] - Neoplasms [C04]; Analytical, Diagnostic and Therapeutic Techniques and Equipment [E] - Investigative Techniques [E05]
Gender: Female, Male. Age: 18-64 years, 65+ years. Enrolment: 24.
Status: Ongoing, recruiting. Start date (EU): 2025-11-03. Decision date: 2024-10-21. Results received: No. Last updated: 2024-10-21.

Condition(s): Non small cell lung cancer
Product: Natriumchloride 0,9% oplossing voor injectie, IMJUDO 20 mg/ml concentrate for solution for infusion.

Primary endpoint: Safety defined as the proportion of patients with (severe) adverse events up to the date of the scheduled surgical lung tumor resection after intra-nodal and intra-tumoral bronchoscopic administration of tremelimumab. This includes both TBNI procedure related (S)AEs and immune-related (S)AEs., Feasibility defined as successful injection of tremelimumab or saline in the tumor draining lymph node or tumor.
Endpoint(s): Pharmacokinetics assessment: levels of therapeutic antibodies in plasma at multiple time points (baseline, 2 hours post TBNI procedure, 1 day post TBNI, 14 (+/- 5 days) days post TBNI and 12 weeks (+/- 7 days) after surgical lung tumor resection ).

Source: https://euclinicaltrials.eu/ctis-public/view/2024-511878-67-00